EU clinical trial 2024-518229-13-00: A clinical study of MK-2828 in healthy people (MK-2828-002)
Protocol code: MK-2828-002
Sponsor: Merck Sharp & Dohme LLC (Pharmaceutical company). Phase: Human Pharmacology (Phase I)- Other. Countries: Belgium (ended).
Therapeutic area(s): Diseases [C] - Cardiovascular Diseases [C14]
Gender: Male. Age: 18-64 years. Enrolment: 40.
Status: Ended. Start date (EU): 2025-01-21. End date (EU): 2025-07-04. End date: 2025-07-05. Decision date: 2024-12-20. Results received: No. Last updated: 2024-12-20.

Condition(s): Atherosclerosis

Source: https://euclinicaltrials.eu/ctis-public/view/2024-518229-13-00